EU clinical trial 2023-508671-37-00: An Open-Label, Multicenter, Phase 2 Study of CLR 131 in Patients with Relapsed or Refractory (R/R) Select B-Cell Malignancies (CLOVER-1) and Expansion Cohort in Patients with Waldenstrom Macroglobulinemia (CLOVER-WaM)
Protocol code: DCL-16-001
Sponsor: Cellectar Biosciences Inc. (Pharmaceutical company). Phase: Therapeutic exploratory (Phase II). Countries: Greece (ongoing, recruitment ended), France (ended), Spain (ended).
Therapeutic area(s): Diseases [C] - Neoplasms [C04]
Gender: Female, Male. Age: 18-64 years, 65+ years. Enrolment: 12.
Start date (EU): 2021-12-02. Decision date: 2024-07-08. Results received: No. Last updated: 2026-02-18.
Decision dates by country: FR: 2024-07-10, ES: 2024-07-08, GR: 2024-08-26

Condition(s): Waldenstrom Macroglobulinemia
Product: POTASSIUM IODIDE

Primary endpoint: The primary endpoint is the MRR, which is defined as the proportion of patients following the infusion of CLR 131 with complete response (CR), very good partial response (VGPR), or partial response (PR) determined from criteria modified from the VIth Waldenstrom’s Macroglobulinemia Criteria for Response Assessment up to 12 months post first CLR 131 infusion in WM patients who have received at least two prior lines of therapy.
Endpoint(s): 1. Overall response rate (ORR), defined as the proportion of patients with a MR, PR, VGPR, or CR determined from criteria modified from the VIth Waldenstrom’s Macroglobulinemia Criteria for Response Assessment., 2. Treatment free survival (TFS), defined as the time from last CLR 131 dose to time to initiation of subsequent therapy or death., 3. Duration of response (DOR) is defined as the time from the first documentation of response (including CR, VGPR, PR) to PD or death. For DOR, patients who are alive and progression free during this study will have their event time censored on the last disease assessment., 4. Clinical benefit rate (CBR) is defined as the proportion of patients with CR, VGPR, PR, MR, and SD determined from criteria modified from the VIth Waldenstrom’s Macroglobulinemia Criteria for Response Assessment., 5. Safety. Adverse events (AEs), serious AE (SAEs), AEs with Grade ≥ 3, laboratory results, vital signs, electrocardiogram (ECG), and Eastern Cooperative Oncology Group (ECOG) performance status (PS).

Source: https://euclinicaltrials.eu/ctis-public/view/2023-508671-37-00